EU clinical trial 2025-521221-32-00: Randomized, Open-Label, Phase 3 Clinical Trial of N-803 Plus Tislelizumab and Docetaxel Versus Docetaxel Monotherapy in Participants With Advanced or Metastatic Non-Small Cell Lung Cancer who Have Acquired Resistance to Immune Checkpoint Inhibitor Therapy
Protocol code: ResQ201A-NSCLC
Sponsor: Immunitybio Inc. (Pharmaceutical company). Phase: Therapeutic confirmatory (Phase III). Countries: Germany (authorised, recruitment pending), Hungary (authorised, recruitment pending), Spain (authorised, recruitment pending), Poland (authorised, recruitment pending), Greece (authorised, recruitment pending), Belgium (authorised, recruitment pending), France (authorised, recruitment pending), Italy (authorised, recruitment pending), Romania (authorised, recruitment pending).
Therapeutic area(s): Diseases [C] - Respiratory Tract Diseases [C08]; Diseases [C] - Neoplasms [C04]
Gender: Female, Male. Age: 18-64 years, 65+ years. Enrolment: 206.
Status: Authorised, recruitment pending. Decision date: 2025-08-26. Results received: No. Last updated: 2026-05-29.
Decision dates by country: DE: 2025-08-26, HU: 2026-01-20, PL: 2026-02-08, ES: 2026-02-09, GR: 2026-04-24, BE: 2026-05-06, FR: 2026-05-18, IT: 2026-05-08, RO: 2026-04-22

Condition(s): Advanced or Metastatic Non-Small Cell Lung Cancer
Product: Tislelizumab, Docetaxel Seacross 20 mg/ml concentrado para solução para perfusão, N-803 (NAI)

Primary endpoint: Overall Survival (OS)
Endpoint(s): Efficacy - Compare immune DCR (iDCR), immune progression-free survival (iPFS), immune overall response rate (iORR), and immune duration of response (iDOR) as measured using immune Response Evaluation Criteria in Solid Tumors (iRECIST) between the experimental and control arms. Safety - Compare safety between the experimental and control arms.

Source: https://euclinicaltrials.eu/ctis-public/view/2025-521221-32-00